EU clinical trial 2022-502144-12-00: FAMODREP : Interest of Famotidine in Reducing Endothelial Expression of P-selectin in Children With Sickle Cell Disease: Pilot Study, Single-center, Prospective, Non-comparative
Protocol code: APHP201133
Sponsor: Assistance Publique Hopitaux De Paris (Hospital/Clinic/Other health care facility). Phase: Therapeutic use (Phase IV). Countries: France (ended).
Therapeutic area(s): Diseases [C] - Hemic and Lymphatic Diseases [C15]
Gender: Female, Male. Age: 0-17 years. Enrolment: 30.
Status: Ended. Start date (EU): 2022-01-12. End date (EU): 2022-12-12. Decision date: 2022-12-20. Results received: Yes. Last updated: 2022-12-20.

Condition(s): Sickle Cell Disease
Product: FAMOTIDINE

Primary endpoint: The primary endpoint will be the difference in the plasma concentration of soluble P-selectin measured by ELISA technique (Human P-selectin / CD62P Quantikine ELISA kit, R&D) before and after 29 days of treatment with famotidine.
Endpoint(s): The differences in plasma concentration of soluble adhesion molecules E-selectin, VCAM-1, and ICAM-1 measured by ELISA technique (Human E-selectin / CD62E, Human sVCAM-1 / CD106 and Human ICAM-1 / CD54 Quantikine ELISA kits, R&D) before and after 29 days of treatment with famotidine., The differences in blood values of hemoglobin, reticulocytes, ASAT, free bilirubin, LDH, and CRP (measured in the hematology / hemostasis and biochemistry laboratories of the Necker-Enfants Malades hospital) before and after 29 days of treatment by famotidine., Occurrence of serious or non-serious adverse event (s), CVO occurrence

Source: https://euclinicaltrials.eu/ctis-public/view/2022-502144-12-00